EU clinical trial 2023-509170-33-00: A Randomized, Double-Blind, Placebo-Controlled Study to Evaluate the Safety and Efficacy of Crinecerfont (NBI-74788) in Pediatric Subjects with Classic Congenital Adrenal Hyperplasia, Followed by Open-Label Treatment
Protocol code: NBI-74788-CAH2006
Sponsor: Neurocrine Biosciences Inc. (Pharmaceutical company). Phase: Therapeutic confirmatory (Phase III). Countries: Germany (ongoing, recruitment ended), France (ongoing, recruitment ended), Belgium (ongoing, recruitment ended), Spain (ongoing, recruitment ended), Poland (ongoing, recruitment ended), Greece (ongoing, recruitment ended), Italy (ongoing, recruitment ended).
Therapeutic area(s): Diseases [C] - Hormonal diseases [C19]
Gender: Female, Male. Age: 0-17 years. Enrolment: 35.
Status: Ongoing, recruitment ended. Start date (EU): 2021-11-23. Decision date: 2024-05-24. Results received: No. Last updated: 2026-01-14.
Decision dates by country: BE: 2024-05-29, FR: 2024-05-24, GR: 2024-07-02, IT: 2024-07-01, ES: 2024-05-28, PL: 2024-05-27, DE: 2024-05-28

Condition(s): Classic Congenital Adrenal Hyperplasia (CAH)
Product: Crinecerfont placebo for oral solution, NBI-74788, NBI-74788, Crinecerfont placebo for oral Capsules

Primary endpoint: Change from baseline in serum androstenedione at Week 4.
Endpoint(s): Change from baseline in serum 17-hydroxyprogesterone at Week 4, Percent change from baseline in glucocorticoid dose at Week 28

Source: https://euclinicaltrials.eu/ctis-public/view/2023-509170-33-00